EU clinical trial 2024-512640-36-00: A Phase 1b, Open-Label Study of Eftozanermin Alfa (ABBV-621) in Combination with Bortezomib and Dexamethasone in Subjects with Relapsed or Refractory Multiple Myeloma
Protocol code: M20-258
Sponsor: AbbVie Deutschland GmbH & Co. KG (Pharmaceutical company). Phase: Human Pharmacology (Phase I)- Other. Countries: Italy (ended).
Therapeutic area(s): Diseases [C] - Neoplasms [C04]
Gender: Female, Male. Age: 18-64 years, 65+ years. Enrolment: 1.
Status: Ended. Start date (EU): 2021-05-26. End date (EU): 2025-05-05. End date: 2025-05-06. Decision date: 2024-08-05. Results received: No. Last updated: 2024-08-05.

Condition(s): Multiple Myeloma

Source: https://euclinicaltrials.eu/ctis-public/view/2024-512640-36-00